EU clinical trial 2025-523808-75-00: Randomised, crossover bioequivalence clinical trial of memantine 20 mg capsules versus memantine 20 mg film-coated tablets, after a single oral dose administration to healthy volunteers under fasting conditions.
Protocol code: UECHUP-MEM/25-6
Sponsor: Laboratorios Alter S.A. (Pharmaceutical company). Phase: Human Pharmacology (Phase I)- Bioequivalence Study. Countries: Spain (ended).
Therapeutic area(s): Psychiatry and Psychology [F] - Mental Disorders [F03]
Gender: Female, Male. Age: 18-64 years. Enrolment: 24.
Status: Ended. Start date (EU): 2025-10-24. End date (EU): 2025-12-18. Decision date: 2025-10-09. Results received: No. Last updated: 2025-10-09.

Condition(s): Alzheimer’s disease

Source: https://euclinicaltrials.eu/ctis-public/view/2025-523808-75-00